EU clinical trial 2024-517845-14-00: TestOsterone TreatmEnt on Neuroprotection and Myelin Repair in Relapsing Remitting Multiple Sclerosis (TOTEM-RRMS)
Protocol code: 7109
Sponsor: Les Hopitaux Universitaires De Strasbourg (Hospital/Clinic/Other health care facility). Phase: Therapeutic exploratory (Phase II). Countries: France (ongoing, recruitment ended).
Therapeutic area(s): Diseases [C] - Nervous System Diseases [C10]
Gender: Male. Age: 18-64 years. Enrolment: 80.
Status: Ongoing, recruitment ended. Start date (EU): 2024-10-03. Decision date: 2024-10-03. Results received: No. Last updated: 2025-06-16.

Condition(s): Relapsing Remitting Multiple sclerosis
Product: Placebo to Nebido, NEBIDO 1000 mg/4 ml, solution injectable

Primary endpoint: Binary criterion comparing the success rate in each treatment group, defined by thalamic atrophy less than 0.5% per year and / or a decrease in transverse diffusivity in lesions less than 0.5% per year.
Endpoint(s): Efficiency of treatment by imaging: XML File Identifier: 0bHUQtIJ9JZx4QdRJTxm0++LBOc= Page 13/24 • evolution of conventional MRI parameters: volume and number of T1 hypointense lesions, volume and number of new or enlarged T2 lesions, total volume of hyper-intensity FLAIR. • evolution of unconventional MRI parameters: diffusion tensor imaging (NODDI), quantitative magnetization transfer imaging (MPF)., Clinical efficiency of treatment: • Brief International Cognitive Assessment for Multiple Sclerosis, test consisting of the symbol digit modalities test, the California Verbal Learning Test Second Edition, and the Brief Visuospatial Memory Test Revised test • Changes in quality of life and health-related quality of life as measured by the SF-36 and EQ-5D questionnaires respectively., Clinical efficiency of treatment:Impact of MS on workplace productivity and day-to-day activities, as assessed by the WPAI (Work productivity and activity impairment) questionnaire. • Impact on fatigue, as measured by the Multi-Dimensional Fatigue Impact Scale (MFIS),, Clinical efficiency of treatment:Hospital assessment scale for anxiety and depression, as measured by the hospital anxiety and depression scale (HADS) questionnaire. • Evolution of handicap by the EDSS Score, Safe use of the treatment: number and nature of adverse events, evaluation of vital signs at each visit, clinical and neurological examinations, biological results, locally interpreted MRI for tolerance (non-MS pathology of the CNS) and monitoring of concomitant medications ( outside Tysabri®).

Source: https://euclinicaltrials.eu/ctis-public/view/2024-517845-14-00